EU clinical trial 2022-501454-11-00: International cooperative prospective study for children and adolescents with standard risk ALK-positive anaplastic large cell lymphoma (ALCL) estimating the efficacy of Vinblastine
Protocol code: ALCL-VBL
Sponsor: GPOH gGmbH (Patient organisation/association). Phase: Therapeutic confirmatory (Phase III). Countries: Austria (authorised, recruiting), Germany (ongoing, recruiting), Netherlands (ongoing, recruiting), Belgium (ongoing, recruiting), Denmark (ongoing, recruiting), France (ongoing, recruiting), Finland (authorised, recruiting), Sweden (authorised, recruitment pending).
Therapeutic area(s): Diseases [C] - Neoplasms [C04]
Gender: Female, Male. Age: 0-17 years. Enrolment: 137.
Start date (EU): 2020-02-05. Decision date: 2023-02-23. Results received: No. Last updated: 2026-07-08.
Decision dates by country: NL: 2023-02-23, BE: 2023-07-13, FR: 2023-11-02, DK: 2023-06-30, DE: 2023-03-01, SE: 2025-12-08, FI: 2024-01-26, AT: 2023-03-01

Condition(s): standard risk ALK-positive anaplastic large cell lymphoma (ALCL)
Product: VINBLASTINE SULFATE

Primary endpoint: Probability of event-free-survival (pEFS) at 3 years, with EFS defined as the time of diagnosis to the first event (progressive disease, nonresponse, secondary malignancy or death due to any cause) or last follow-up.

Source: https://euclinicaltrials.eu/ctis-public/view/2022-501454-11-00